EU clinical trial 2025-522023-10-00: Testosterone supplementation in patients in best supportive care: impact on quality of life.
Protocol code: IJB-SP01-2025
Sponsor: Institut Jules Bordet (Hospital/Clinic/Other health care facility). Phase: Therapeutic exploratory (Phase II). Countries: Belgium (authorised, recruiting).
Therapeutic area(s): Diseases [C] - Neoplasms [C04]
Gender: Male. Age: 18-64 years. Enrolment: 25.
Status: Authorised, recruiting. Start date (EU): 2026-02-11. Decision date: 2025-09-29. Results received: No. Last updated: 2026-07-03.
Decision dates by country: BE: 2025-10-31

Condition(s): Androgen deficiency, palliative care
Product: Sustanon 250, solution injectable

Primary endpoint: Best improvement over time in independence using the ADL independence scale in terms of personal hygiene, dressing, going to the toilet, locomotion, continence and eating, Best improvement over time in symptoms of pain, fatigue, sadness, anxiety, drowsiness, appetite, sense of well-being, shortness of breath, bowel movements and strength using the Edmonton Symptom Assessment Scale
Endpoint(s): The average of ADL and Edmonton Symptom Assessment Scale during treatment after baseline. The ADL and Edmonton System Assessment Scale at each time point during treatment, especially at D15., Improvement of quality of life of subjects from the point of view of a proxy using the EQ-5D-3L questionnaire.

Source: https://euclinicaltrials.eu/ctis-public/view/2025-522023-10-00